EU clinical trial 2024-513283-26-00: A Phase 2 Study of Cusatuzumab Plus Azacitidine in Patients With Newly Diagnosed Acute Myeloid Leukemia who are not Candidates for Intensive Chemotherapy
Protocol code: CULM20236
Sponsor: OncoVerity Inc. (Pharmaceutical company). Phase: Therapeutic exploratory (Phase II). Countries: Spain (ended).
Therapeutic area(s): Diseases [C] - Neoplasms [C04]
Gender: Female, Male. Age: 18-64 years, 65+ years. Enrolment: 1.
Status: Ended. Start date (EU): 2019-08-20. End date (EU): 2026-03-06. Decision date: 2024-07-11. Results received: No. Last updated: 2025-05-05.

Condition(s): Acute Myeloid Leukemia
Product: Cusatuzumab, AZACITIDINE, AZACITIDINE

Primary endpoint: Complete response (CR) rate per ELN 2017 (Dohner 2017)
Endpoint(s): Rate of CRh, Rate of CR + CRh, Rate of Cri, Overall response rate (ORR) = Rate of CR+ CRh+ CRi, Rate of CR without MRD, Rate of MRD negativity among participants achieving CR, CRh, CRi, or MLFS; defined as less than 1 blast or leukemic stem cell in 1,000 leukocytes (MRD level <10^-3), Time to response, defined as time from randomization in Part 1 or enrollment in Part 2 to achieving the first response of CR, CRh, or CRi; duration of response, defined as time from achieving the first response of CR, CRh, or CRi to disease relapse or death from any cause., Transfusion independence (RBC or platelets) is defined as a period of at least 56 consecutive days with no transfusion between first dose of study drug and the last dose of study drug + 30 days., Safety profile of Adverse Events (AE) and Serious Adverse Events (SAE), Pharmacokinetics, Immunogenicity / anti-drug antibody testing

Source: https://euclinicaltrials.eu/ctis-public/view/2024-513283-26-00